EU clinical trial 2023-504577-21-00: A phase IV, unicentric, open label clinical trial to evaluate the default mode network in multiple sclerosis patients on Cladribine treatment.
Protocol code: CLADRI_NET
Sponsor: María Luisa Martínez Ginés (Health care). Phase: Therapeutic use (Phase IV). Countries: Spain (expired).
Therapeutic area(s): Diseases [C] - Nervous System Diseases [C10]
Gender: Female, Male. Age: 18-64 years. Enrolment: 20.
Status: Expired. Decision date: 2023-06-26. Results received: No. Last updated: 2023-06-26.

Condition(s): Multiple Sclerosis
Product: MAVENCLAD 10 mg tablets

Primary endpoint: Changes in resting state functional activity indexes (rs-fMRI) at 18 months compared to baseline
Endpoint(s): Changes in resting state functional activity indexes (rs-fMRI) after 18 months of cladribine treatment, Changes in Image Tensor Diffusion of main cerebral tracts after 18 months of cladribine treatment., Changes in volumetric measures from key brain region (corpus callosum, thalamus and hippocampus) after 18 months of cladribine treatment, The contribution of cortico-cerebellar connectivity to MS cognitive performance after 18 months of cladribine treatment, Changes in cortical Atrophy Index after 18 months of cladribine treatment after 18 months of cladribine treatment., Changes in Brain Activity during processing speed task after 18 months of cladribine treatment., Changes in cognitive functioning indexes measured with neuropsychological tests after 18 months of cladribine treatment., Changes in emotional/behavioural indexes measured with neuropsychological tests after 18 months of cladribine treatment., Changes in clinical neurological status measured with EDSS and ARR after 18 months of cladribine treatment.

Source: https://euclinicaltrials.eu/ctis-public/view/2023-504577-21-00